EU clinical trial 2024-514620-17-00: STARTREC - Can we Save the rectum by watchful waiting or transanal surgery following short- or long-course radioTherapy and Additional local oR systemic Treatment for early-stage REctal Cancer?
Sponsor: Radboud universitair medisch centrum Stichting (Hospital/Clinic/Other health care facility). Phase: Therapeutic exploratory (Phase II). Countries: Netherlands (ongoing, recruiting).
Therapeutic area(s): Diseases [C] - Neoplasms [C04]
Gender: Female, Male. Age: 18-64 years, 65+ years. Enrolment: 210.
Status: Ongoing, recruiting. Start date (EU): 2024-10-14. Decision date: 2024-08-30. Results received: No. Last updated: 2025-11-06.

Condition(s): Patients with early-stage rectal cancer (defined as early rectal cancer cT1-3abN0M0 or early-intermediate rectal cancer cT1-3abN1(≤3 nodes ≤8mm)M0
Product: CAPECITABINE, OXALIPLATIN

Primary endpoint: the proportion of patients with successful organ preservation at 24 months from the start of treatment.
Endpoint(s): Patient- and clinician-reported acute (<3 months following completion of treatment) and late (<1 year following completion of treatment) treatment-related toxicity, Proportion of patients with a clinical complete response at 26 weeks (6 months) after onset of treatment, Proportion of patients undergoing transanal local excision, Complications within the first 30 days after completion or salvage TME-surgery, in terms of postoperatieve morbidity and mortality rates defined by Clavien-Dindo, Proportion of patients (in each group) with a stoma at 12 months, Time to event of organ loss assessed for patients who prefer organ preservation; defined as the length of time from the start date of trial treatment until TME surgery, Regrowth rate at 36 months; defined as endoluminal or locoregional nodal regrowth detected during W&W follow-up, Metastasis-free survival to 24 months; defined as the length of time from the start date of trial treatment until death (any cause) or detection of distant metastasis, Non-regrowth-disease free survival to 24 months; defined as the length of time from the start of trial treatment until death (any cause), detection of local pelvic recurrence or distant metastasis but not including patients who developed local regrowth which was resected with clear margins using standard TME surgery, Overall survival to 36 months; defined as the length of time from the start date of trial treatment until death (any cause), Health Related Quality of Life (HR QoL) standardly measured by EORTC general and colorectal cancer specific quality of life questionnaire (QLQ‐CR29, QLQ‐C30 and EQ-5D-5L) (baseline and at 6 and 24 months); Decision Regret Scale one-time at 24 monts, Functional outcome: bowel, bladder and sexual dysfunction measured by low anterior resection syndrome (LARS) score, The International Consultation on Incontinence Modular Questionnaire on Male Lower Urinary Tract Symptoms (ICIQ‐ MLUTS)/ ICIQ‐Female Lower Urinary Tract Symptoms (ICIQ‐FLUTS) questionnaires (baseline and at 6 and 24 months)

Source: https://euclinicaltrials.eu/ctis-public/view/2024-514620-17-00